EU clinical trial 2022-502632-39-00: A Study to Investigate the Safety, Tolerability, Pharmacokinetics and Pharmacodynamics of RO7507062 in Participants with Systemic Lupus Erythematosus
Protocol code: BP44315
Sponsor: F. Hoffmann-La Roche AG (Pharmaceutical company). Phase: Human Pharmacology (Phase I)- First administration to humans. Countries: Poland (ongoing, recruitment ended), Spain (ongoing, recruitment ended), Germany (ongoing, recruitment ended), Netherlands (ended), France (ongoing, recruitment ended).
Therapeutic area(s): Diseases [C] - Immune System Diseases [C20]
Gender: Female, Male. Age: 18-64 years, 65+ years. Enrolment: 35.
Start date (EU): 2023-10-11. Decision date: 2023-08-31. Results received: No. Last updated: 2026-06-11.
Decision dates by country: NL: 2023-09-13, FR: 2024-08-09, ES: 2023-09-13, PL: 2023-09-04, DE: 2023-09-01

Condition(s): Systemic Lupus Erythematosus (SLE)

Source: https://euclinicaltrials.eu/ctis-public/view/2022-502632-39-00